EU clinical trial 2024-513874-23-00: INDICIA: evolution of the initial distribution volume of glucose in the severe burned adults
Protocol code: 2023-03-CHRMT
Sponsor: Centre Hospital Region Metz Thionville (Hospital/Clinic/Other health care facility). Phase: Therapeutic exploratory (Phase II). Countries: France (ongoing, recruiting).
Therapeutic area(s): Diseases [C] - Skin and Connective Tissue Diseases [C17]
Gender: Female, Male. Age: 18-64 years, 65+ years. Enrolment: 15.
Status: Ongoing, recruiting. Start date (EU): 2024-11-27. Decision date: 2024-09-03. Results received: No. Last updated: 2024-09-03.

Condition(s): Severe burns
Product: GLUCOSE 30 % PROAMP, solution injectable

Primary endpoint: The IDVG is calculated according to the method described by Hitota et al. A reference blood glucose level is measured on an arterial blood sample (arterial catheter) by a blood glucose meter. A bolus of 5 g of glucose is injected into a central venous line over 30 seconds. A second blood glucose level is measured 3 minutes after the end of the injection. The difference between the two blood glucose levels is recorded as d[glu] in mg/dl. IDVG = 24.4 x e(-0.0298 * d[glu]) + 2.7 in liters
Endpoint(s): ITBV (intra-thoracic blood volume) and EVLW (extra-vascular lung water) measured at the same time as IDVG, using the PiCCO device and trans-lung dilution of a thermal indicator (cold saline)., Body surface area assessed on admission (Wallace method), Water intake and input/output balance (water intake minus diuresis), In-hospital mortality, Arterial blood glucose levels will be measured in g/L just before and 3 minutes after the end of the glucose bolus injection, using a glucometer.

Source: https://euclinicaltrials.eu/ctis-public/view/2024-513874-23-00